EU clinical trial 2024-518985-29-02: DUET-study: A FEASIBILITY STUDY OF 177LU-PSMA RADIOLIGAND THERAPY ALTERNATED WITH RADIUM-223 IN PATIENTS WITH BONE-METASTATIC, OLIGO-METASTATIC HORMONE-SENSITIVE PROSTATE CANCER AFTER CURATIVE THERAPY.
Protocol code: DUET study
Sponsor: Amsterdam UMC Stichting (Patient organisation/association). Phase: Phase I and Phase II (Integrated)- First administration to humans. Countries: Netherlands (ended).
Therapeutic area(s): Analytical, Diagnostic and Therapeutic Techniques and Equipment [E] - Therapeutics [E02]; Diseases [C] - Male Urogenital Diseases [C12]
Gender: Male. Age: 18-64 years, 65+ years. Enrolment: 6.
Status: Ended. Start date (EU): 2024-11-21. End date (EU): 2026-04-02. Decision date: 2024-12-04. Results received: No. Last updated: 2025-07-22.

Condition(s): Prostate cancer
Product: Lutetium Lu-177 PSMA I&T Injection, Xofigo 1100 kBq/mL solution for injection

Primary endpoint: The feasibility and safety of drug application in patients with bone metastatic, oligometastatic, HSPCa after curative therapy (i.e., radical prostatectomy) treated by alternated Radium-223 RLT and 177Lu-PSMA RLT., The proposed treatment schedule is considered unfeasible when treatment is postponed more than 4 weeks in more than 50% of participants due to treatment related toxicity (myelosuppression or xerostomia), or when treatment had to be cancelled due to unwillingness of patients to continue (or complete) treatment.
Endpoint(s): The tolerability (toxicity) of study medication (i.e., Ra-223 RLT and 177Lu-PSMA RLT), the health-related quality of life (HRQoL) and the incidence of xerostomia by patient reported outcome measures (PROMS) using the RAND-36 and the xerostomia inventory, at baseline and repeatedly each two weeks after initiation of 177Lu-PSMA RLT and after the last treatment., the prostate-specific antigen (PSA) free survival at 3,6 and 12 months after combined cytotoxic RLT, i.e., 177Lu-PSMA RLT and Radium-223 RLT., the radiological response on PSMA PET/CT, bone scan and CT abdomen and thorax performed three months after last treatment (± 3 weeks).

Source: https://euclinicaltrials.eu/ctis-public/view/2024-518985-29-02